EU clinical trial 2022-501018-78-00: A Phase 3 Randomized, Placebo-Controlled, Double-Blind Program to Evaluate Efficacy and Safety of Upadacitinib in Adult Subjects with Axial Spondyloarthritis Followed by a Remission-Withdrawal Period
Protocol code: M19-944
Sponsor: Abbvie Deutschland GmbH & Co. KG (Pharmaceutical company). Phase: Therapeutic confirmatory (Phase III). Countries: Germany (ended), France (ended), Bulgaria (ended), Hungary (ended), Poland (ended), Spain (ended), Slovakia (ended), Czechia (ended), Belgium (ended).
Therapeutic area(s): Diseases [C] - Immune System Diseases [C20]
Gender: Female, Male. Age: 18-64 years, 65+ years. Enrolment: 272.
Status: Ended. Start date (EU): 2020-03-23. End date (EU): 2024-04-30. End date: 2025-02-28. Decision date: 2022-12-06. Results received: Yes. Last updated: 2022-12-13.
Decision dates by country: BE: 2022-12-12, BG: 2022-12-12, CZ: 2022-12-12, FR: 2022-12-06, DE: 2022-12-09, HU: 2022-12-08, ES: 2022-12-13, PL: 2022-12-12, SK: 2022-12-06

Condition(s): Axial Spondyloarthritis
Product: Upadacitinib, Upadacitinib matching placebo

Primary endpoint: Study 1 - Primary endpoint is ASAS 40 response at week 14, Study 2 - Primary endpoint is ASAS 40 response at week 14
Endpoint(s): Study 1: Change from Baseline in Ankylosing Spondylitis Disease Activity Score (ASDAS), Study 1: Change from Baseline in magnetic resonance imaging (MRI) Spondyloarthritis Research Consortium of Canada (SPARCC) score (spine), Study 1: Bath Ankylosing Spondylitis Disease Activity Index (BASDAI) 50 response, Study 1: ASAS20 response, Study 1: ASDAS Inactive Disease (ASDAS score < 1.3), Study 1: Change from Baseline in Patient's Assessment of Total Back Pain (Total Back Pain), Study 1: Change from Baseline in Patient's Assessment of Nocturnal Back Pain (Nocturnal Back Pain), Study 1: ASDAS Low Disease Activity (ASDAS score < 2.1), Study 1: Change from Baseline in Bath Ankylosing Spondylitis Functional Index (BASFI), Study 1: ASAS partial remission (PR) (an absolute score of ≤ 2 units for each of the 4 domains identified in ASAS 40), Study 1: Change from Baseline in Ankylosing Spondylitis Quality of Life (ASQoL), Study 1: Change from Baseline in ASAS Health Index (HI), Study 1: Change from Baseline in linear bath Ankylosing Spondylitis Metrology Index (BASMIlin)., Study 1: Change from Baseline in Maastricht Ankylosing Spondylitis Enthesitis Score (MASES)., Study 2: Change from Baseline in ASDAS, Study 2: Change from Baseline in MRI SPARCC score (SI joints), Study 2: BASDAI 50 response, Study 2: ASDAS Inactive Disease (ASDAS score < 1.3), Study 2: Change from Baseline in Patient's Assessment of Total Back Pain (Total Back Pain), Study 2: Change from Baseline in Patient's Assessment of Nocturnal Back Pain (Nocturnal Back Pain), Study 2: ASDAS Low Disease Activity (ASDAS score < 2.1), Study 2: ASAS PR (an absolute score of ≤ 2 units for each of the 4 domains identified in ASAS40), Study 2: Change from Baseline in BASFI, Study 2: Change from Baseline in ASQoL, Study 2: Change from Baseline in ASAS HI, Study 2: ASAS20 response, Study 2: Change from Baseline in BASMIlin, Study 2: Change from Baseline in MASES, Study 2: ASAS40 response at Week 52

Source: https://euclinicaltrials.eu/ctis-public/view/2022-501018-78-00